EU clinical trial 2024-518018-22-00: Rifampin-free regimen versus rifampin-containing regimen in the treatment of staphylococcal prosthetic valve endocarditis: a multicenter randomized controlled non-inferiority study (RIFREE)
Protocol code: RC24_0404
Sponsor: Centre Hospitalier Universitaire De Nantes (Hospital/Clinic/Other health care facility). Phase: Therapeutic confirmatory (Phase III). Countries: France (ongoing, recruiting).
Therapeutic area(s): Diseases [C] - Bacterial Infections and Mycoses [C01]; Diseases [C] - Cardiovascular Diseases [C14]
Gender: Female, Male. Age: 18-64 years, 65+ years. Enrolment: 422.
Status: Ongoing, recruiting. Start date (EU): 2026-06-11. Decision date: 2025-08-28. Results received: No. Last updated: 2025-08-28.

Condition(s): staphylococcal endocarditis
Product: Zinforo 600 mg powder for concentrate for solution for infusion, CEFAZOLINE VIATRIS 1 g, poudre pour solution injectable (IM-IV), VANCOMYCINE SANDOZ 500 mg, poudre pour solution à diluer pour perfusion ou pour solution buvable, RIFADINE IV 600 mg, poudre et solvant pour solution pour perfusion, PLACEBO, COTRIMOXAZOLE TEVA 800 mg/160 mg, comprimé, DAPTOMYCINE MEDAC 350 mg, poudre pour solution injectable/pour perfusion, LEVOFLOXACINE ARROW LAB 500 mg, comprimé pelliculé sécable, RIMACTAN 300 mg, gélule, RIFADINE 300 mg, gélule

Primary endpoint: All-cause mortality rate at 6 months post randomization
Endpoint(s): 1)a)Within 6 months after randomization: Proportions of patients with at least one microbiological failure defined by bacteremia with the primary pathogen obtained during follow-up but before the end of curative treatment, 1)b)Within 6 months after randomization: Proportions of patients with at least one relapse defined by bacteremia with the primary pathogen obtained during follow-up after the end of treatment of endocarditis, 1)c)Within 6 months after randomization: Proportions of patients with at least one clinically evident embolic event defined as secondary osteoarticular, splenic, brain or other symptomatic localizations, 1)d)Within 6 months after randomization: Proportions of patients with at least one valvular surgery, 1)e)Within 6 months after randomization: Proportions of patients with clinical failure defined by a composite criterion: all-cause mortality or microbiological failure or relapse or embolic event or valvular surgery, 1)f)Within 6 months after randomization: Time to clinical failure, 1)g)Within 6 months after randomization: Proportions of patients with at least one adverse event grade III/IV related to treatment, 1)h)Within 6 months after randomization: Proportions of patients with at least one bleeding complication, 1)i)Within 6 months after randomization: Length of stay in hospital, 1)j)Within 6 months after randomization: Duration of curative antibiotic treatment for endocarditis, 2)All-cause mortality rates at discharge and at 3 months after randomization, 3)a) Within 12 months after randomization: Proportions of patients with at least one readmission in hospital (whatever the reason), 3)b)Within 12 months after randomization: Proportions of patients with at least one valvular surgery, 3)c)Within 12 months after randomization: All-cause mortality rates, 3)d)Within 12 months after randomization: Proportions of patients with at least one relapse, 4) Microbiological analysis of relapse: Proportions of patients with reclassification of relapse/failure as reinfection, Identification of clinical and biological factors associated with relapse, Proportions of patients with relapse in patients with surgery and without surgery, Identify a common heritable trait in the staphylococcal strains associated with the occurrence of relapse, 5)Incremental cost-effectiveness ratio (cost per quality-adjusted life year (QALYs) gained) comparing the two arms.

Source: https://euclinicaltrials.eu/ctis-public/view/2024-518018-22-00